EU clinical trial 2024-520167-13-00: A Phase 3, Open-Label, Single-Arm, Multicenter Study to Evaluate the Pharmacokinetics, Pharmacodynamics, Efficacy, and Safety of Ravulizumab in Pediatric Participants (2 to < 18 years of age) with Primary Immunoglobulin A Nephropathy (IgAN)
Protocol code: ALXN1210-IgAN-325
Sponsor: Alexion Pharmaceuticals Inc. (Pharmaceutical company). Phase: Therapeutic confirmatory (Phase III). Countries: Spain (ongoing, recruiting), Italy (authorised, recruiting).
Therapeutic area(s): Analytical,Diagnostic,Therapeutic Techniques and Equipment [E]-Surgical Procedures, Operative [E04]; Diseases [C] - Hemic and Lymphatic Diseases [C15]
Gender: Female, Male. Age: 0-17 years. Enrolment: 6.
Start date (EU): 2025-06-17. Decision date: 2025-06-06. Results received: No. Last updated: 2026-03-04.
Decision dates by country: ES: 2025-06-09, IT: 2025-06-06

Condition(s): Immunoglobulin A Nephropathy
Product: Ultomiris 1,100 mg/11 mL concentrate for solution for infusion

Primary endpoint: Change from Baseline in proteinuria based on UPCR at Week 34.
Endpoint(s): 1. PK/PD parameters (at trough and peak) will be evaluated at Baseline and at different timepoints through Week 34 as follows: • PK: Cmax and Ctrough (measured at end of dosing interval) • PD: change in serum free C5 concentrations over time • Change from Baseline in proteinuria based on UPCR at Week 10, Incidence of TEAEs, TESAEs, and AESIs over time., Change from Baseline in vital signs, and laboratory assessments., ADA incidence, ADA response categories, and titer, as well as NAb incidence for the duration of the study.

Source: https://euclinicaltrials.eu/ctis-public/view/2024-520167-13-00